EU clinical trial 2024-515196-35-00: A Phase 1/2 Dose-Escalation and Dose-Expansion Study of ZN-c3 in Combination with Niraparib and ZN-c3 Monotherapy in Subjects with Platinum-resistant Ovarian Cancer.
Protocol code: ZN-c3-006
Sponsor: K-Group Beta Inc. (Pharmaceutical company). Phase: Human Pharmacology (Phase I)- Other. Countries: France (ended).
Therapeutic area(s): Diseases [C] - Neoplasms [C04]
Gender: Female. Age: 18-64 years, 65+ years. Enrolment: 150.
Status: Ended. Start date (EU): 2022-09-29. End date (EU): 2026-01-19. End date: 2026-01-20. Decision date: 2024-11-27. Results received: No. Last updated: 2026-01-06.

Condition(s): Platinum-Resistant Ovarian Cance
Product: Azenosertib (also known as ZN-c3; KP-2638), Azenosertib (also known as ZN-c3; KP-2638), Zejula 100 mg film-coated tablets

Primary endpoint: ZN-c3 with niraparib: • Phase 1: Frequency and severity of dose-limiting toxicities (DLTs) in DLT-evaluable subjects during Cycle 1 (C1)., • Phase 2: – Stage 1 (Futility): Progression-free survival (PFS) at 4 months as defined by the revised Response Evaluation Criteria in Solid Tumors (RECIST) Guideline version 1.1. – Stage 2 (Promising Clinical Activity): Objective response rate (ORR) as defined by the revised RECIST Guideline version 1.1 and assessed by Independent Central Review (ICR)., ZN-c3 monotherapy: • Frequency and severity of adverse events (AEs), including laboratory abnormalities, graded according to the National Cancer Institute Common Terminology Criteria for Adverse Events (NCI-CTCAE) version 5.0. • Incidence of dose interruptions, dose reductions, and permanent treatment discontinuations due to treatment-related AEs • ORR as defined by the revised RECIST Guideline version 1.1 and assessed by ICR.
Endpoint(s): • Duration of response (DOR) as a key secondary endpoint, Clinical benefit rate (CBR), PFS (median and 4-month rate), as defined by the revised RECIST Guideline version 1.1., ORR based on Investigator assessment using RECIST v 1.1, OS (median at 12 months and overall), Frequency and severity of AEs, including laboratory abnormalities, graded according to the NCI-CTCAE version 5.0., Incidence of dose interruptions, dose reductions, and permanent treatment discontinuations due to treatment-related AEs, Ongoing measurement of subject-reported symptomatic toxicity according to the PRO-CTCAE, and determination of change from Baseline in self-reported quality of life using EQ-5D-5L, Plasma PK parameters of ZN-c3 (and its potential metabolites, as applicable) and niraparib.

Source: https://euclinicaltrials.eu/ctis-public/view/2024-515196-35-00